EU clinical trial 2025-523419-12-00: Multiple-Ascending Doses of 2-Methoxyestradiol in Healthy Non-Pregnant Female Participants.
Protocol code: BLCL-2ME-02
Sponsor: Laboratorios Leon Farma S.A. (Pharmaceutical company). Phase: Human Pharmacology (Phase I)- Other. Countries: Portugal (ended).
Therapeutic area(s): Not possible to specify
Gender: Female. Age: 18-64 years. Enrolment: 60.
Status: Ended. Start date (EU): 2025-10-15. End date (EU): 2026-05-15. Decision date: 2025-09-29. Results received: No. Last updated: 2026-05-27.

Condition(s): No medical condition.

Source: https://euclinicaltrials.eu/ctis-public/view/2025-523419-12-00